EU clinical trial 2025-522427-10-00: A phase 2, Multicenter Study of TILs Treatment in Germ Cell tumors: the ARES Study
Sponsor: Fundacio Institut D'Investigacio Biomedica De Bellvitge IDIBELL (Laboratory/Research/Testing facility). Phase: Therapeutic exploratory (Phase II). Countries: Spain (authorised, recruitment pending).
Therapeutic area(s): Diseases [C] - Neoplasms [C04]
Gender: Female, Male. Age: 18-64 years, 65+ years. Enrolment: 10.
Status: Authorised, recruitment pending. Decision date: 2025-11-04. Results received: No. Last updated: 2026-03-27.

Condition(s): Germ Cell Tumors refractory to salvage chemotherapy
Product: ALDESLEUKIN, Tumor Intiltrating Lymphocytes (TIL) – VHIO, FLUDARABINE, CYCLOPHOSPHAMIDE

Primary endpoint: Favorable response rate defined as a complete response per RECIST v1.1 with negative tumor markers (aFP, bHCG, LDH); or a partial response per RECIST v1.1 with a 50% decrease in tumor markers; or stable disease per RECIST v1.1 with negative tumor markers; or growing teratoma as assessed by the investigator.
Endpoint(s): Incidence of Grade ≥3 treatment emergent adverse events (TEAE) according to the National Cancer Institute (NCI) Common Terminology Criteria for Adverse Events (CTCAE) v5.0., Complete Response (CR) Rate per RECIST v1.1 as assessed by investigator with negative tumor markers., Partial response (PR) per RECIST v1.1 with at least 50% decrease in tumor markers., Growing teratoma rate., Duration of response (DOR) per RECIST v1.1 assessed by investigator and tumor markers., Progression-free survival (PFS) defined as the time from the date of treatment administration to the date of first documentation of disease progression or death due to any cause, whichever occurs first. For a patient who has not progressed and is last known to be alive, PFS will be censored at the last response assessment that is stable disease or better., Overall survival (OS) defined from the date of treatment administration to the date of death.

Source: https://euclinicaltrials.eu/ctis-public/view/2025-522427-10-00